EU clinical trial 2024-515293-27-00: Integration of the PD-L1 inhibitor atezolizumab and WT1/DC vaccination into platinum/pemetrexed-based first-line treatment for epithelioid malignant pleural mesothelioma
Protocol code: Immuno-MESODEC
Sponsor: Antwerp University Hospital (Hospital/Clinic/Other health care facility). Phase: Therapeutic exploratory (Phase II). Countries: Belgium (ongoing, recruiting).
Therapeutic area(s): Analytical, Diagnostic and Therapeutic Techniques and Equipment [E] - Therapeutics [E02]; Diseases [C] - Neoplasms [C04]; Phenomena and Processes [G] - Immune system processes [G12]; Diseases [C] - Respiratory Tract Diseases [C08]
Gender: Female, Male. Age: 18-64 years, 65+ years. Enrolment: 15.
Status: Ongoing, recruiting. Start date (EU): 2023-02-24. Decision date: 2024-11-08. Results received: No. Last updated: 2026-07-27.

Condition(s): Malignant pleural mesothelioma, epithelioid subtype (stage I-IV)
Product: Tecentriq 1 200 mg concentrate for solution for infusion, Tecentriq 840 mg concentrate for solution for infusion, WT1 LAMP mRNA DC

Primary endpoint: Feasibility: the proportion of patients who completed study treatment schedule (i.e. administration of four platinum/pemetrexed-based chemotherapy cycles in combination with four atezolizumab treatments and four WT1/DC vaccinations, Safety, based on the occurrence of reported AEs and SAEs during investigational treatment administration and during follow-up: (A) Proportions of patients that experienced (S)AEs possibly, probably or definitely related to pemetrexed and/or cisplatin/carboplatin and/or atezolizumab and/or WT1/DC vaccination (B) Number and grade of AEs and SAEs
Endpoint(s): Clinical efficacy, including: (A) Best overall response (BOR), duration of response (DOR), disease control rate (DCR), objective response rate (ORR) and progression free survival (PFS), (B) Overall survival (OS), Immunogenicity: Functional WT1-specific T cell responses

Source: https://euclinicaltrials.eu/ctis-public/view/2024-515293-27-00